EU clinical trial 2024-518279-80-00: A Phase II, multisite, open-label, trial of pumitamig (BNT327) in combination with standard-of-care chemotherapy in first-line and second-line non-small-cell lung cancer (NSCLC)
Protocol code: BNT327-07
Sponsor: BioNTech SE (Pharmaceutical company). Phase: Therapeutic exploratory (Phase II). Countries: Spain (ongoing, recruiting).
Therapeutic area(s): Diseases [C] - Neoplasms [C04]
Gender: Female, Male. Age: 18-64 years, 65+ years. Enrolment: 10.
Status: Ongoing, recruiting. Start date (EU): 2025-09-19. Decision date: 2025-07-29. Results received: No. Last updated: 2026-07-24.

Condition(s): Non-small Cell Lung Cancer
Product: BNT327, DOCETAXEL

Primary endpoint: Part 1: Occurrence of dose-limiting toxicities (DLTs) during the DLT-evaluation period by dose level. Time Frame: up to 21 days after first dose of investigational medicinal product (IMP)., Part 1 and Part 2: Occurrence of pumitamig treatment-emergent adverse events (TEAEs), TRAEs, treatment-emergent serious adverse events (TESAEs), treatment-related serious adverse events (TRSAEs), and adverse events of special interest (AESIs) graded according to the (US) National Cancer Institute Common Terminology Criteria for Adverse Events (CTCAE). From initiation of the first dose of IMP to the 90-day Follow-Up visit., Part 1 and Part 2: Occurrence of dose interruption, dose reduction, and/or participant discontinuation due to adverse events (AEs). Time Frame: from initiation of the first dose of IMP until the 90-day Safety Follow-up visit., Part 1 and Part 2: Objective response rate (ORR) defined as the proportion of participants in whom a confirmed complete response (CR) or partial response (PR per RECIST v1.1 based on investigator’s review is observed as best overall response). Time Frame: Up to approximately 2 years.
Endpoint(s): Part 1 and Part 2: Duration of response (DOR) defined as the time from first objective response (CR or PR per RECIST v1.1 based on the investigator’s assessment) to first occurrence of objective tumor progression (progressive disease, per RECIST v1.1 based on the investigator’s assessment) or death from any cause, whichever occurs first. Time Frame: Up to approximately 2 years., Part 1 and Part 2: Progression-free survival (PFS) based on the investigator’s assessment defined as the time from first dose of IMP to the first objective tumor progression (progressive disease per RECIST v1.1) or death from any cause, whichever occurs first. Time Frame: Up to approximately 2 years., Part 1 and Part 2: Depth of Response: Defined as the maximum percent reduction from baseline in tumor size measured by sum of target lesion diameter. Time Frame: Up to approximately 2 years., Part 1 and Part 2: Disease Control Rate (DCR) defined as the proportion of participants with confirmed CR, confirmed PR, or stable disease (per RECIST v1.1 based on the investigator’s assessment) as best overall response. Time Frame: Up to approximately 2 years., Part 1 and Part 2: Time to Response (TTR) defined as the time from first dose of IMP to first objective response (CR or PR per RECIST v1.1 based on the investigator’s assessment). Time Frame: Up to approximately 2 years., Part 1 and Part 2: Overall Survival (OS) defined as the time from first dose of IMP to death from any cause. Time Frame: Up to approximately 2 years., Part 1 and Part 2: Based on pumitamig concentrations in serum, the PK parameter Cmax, Part 1 and Part 2: Incidence of detectable anti-pumitamig antibodies in serum from baseline to the end of trial treatment.

Source: https://euclinicaltrials.eu/ctis-public/view/2024-518279-80-00